EU clinical trial 2023-504660-41-00: A Randomized, Double-Blind, Placebo-Controlled Study to Evaluate the Efficacy and Safety of Volixibat in the Treatment of Cholestatic Pruritus in Patients with Primary Biliary Cholangitis (VANTAGE)
Protocol code: VLX-601
Sponsor: Mirum Pharmaceuticals Inc. (Pharmaceutical company). Phase: Therapeutic exploratory (Phase II). Countries: Germany (ongoing, recruitment ended), France (ongoing, recruitment ended), Italy (ongoing, recruitment ended), Netherlands (ongoing, recruitment ended), Spain (ongoing, recruitment ended), Belgium (ongoing, recruitment ended).
Therapeutic area(s): Diseases [C] - Digestive System Diseases [C06]
Gender: Female, Male. Age: 18-64 years, 65+ years. Enrolment: 84.
Status: Ongoing, recruitment ended. Start date (EU): 2022-07-11. Decision date: 2023-08-02. Results received: No. Last updated: 2026-07-07.
Decision dates by country: BE: 2024-03-22, FR: 2023-08-21, NL: 2024-04-17, ES: 2024-04-10, IT: 2023-10-09, DE: 2023-08-02

Condition(s): Cholestatic Pruritus in Patients with Primary Biliary Cholangitis (PBC).
Product: volixibat, volixibat, Volixibat Placebo capsule hard oral use

Primary endpoint: Mean change in Adult ItchRO score comparing baseline with the average of the weekly averaged daily itch scores to the end of the double-blind study treatment.
Endpoint(s): 1. Mean change in sBA levels, 2. Mean change in total bilirubin levels, 3. Mean change in ALP levels, 4.Change in Primary Biliary Cholangitis Quality of Life Measure (PBC-40) from baseline through end of double blind study treatment, 5. Change in Patient-Reported Outcomes Measurement Information System (PROMIS®) fatigue score from baseline to end of double blind study treatment, 6. Change in PROMIS sleep score from baseline to end of double blind study treatment, 7. Proportion of participants achieving a reduction of ≥ 2 points in the weekly averaged daily Adult ItchRO score from baseline to end of double blind study treatment, 8. Incidence of treatment-emergent adverse events (TEAEs), serious adverse events (SAEs), ECIs, and AEs that lead to discontinuation of study drug, 9. Incidence of clinically relevant laboratory abnormalities

Source: https://euclinicaltrials.eu/ctis-public/view/2023-504660-41-00